EU clinical trial 2023-510568-11-00: TARLATEM : Combination of TARLAtamab and TEMozolomide in patients with central nervous system tumors. A multicenter, open-label Phase I/II trial aiming to assess the safety and clinical activity of Tarlatamab in combination with metronomic Temozolomide in adolescents and adults’ patients with high grade brain tumors
Protocol code: ET23-040
Sponsor: Centre Leon Berard (Hospital/Clinic/Other health care facility). Phase: Phase I and Phase II (Integrated)- Other. Countries: France (ongoing, recruiting).
Therapeutic area(s): Diseases [C] - Neoplasms [C04]
Gender: Female, Male. Age: 0-17 years, 18-64 years, 65+ years. Enrolment: 450.
Status: Ongoing, recruiting. Start date (EU): 2025-11-18. Decision date: 2025-08-21. Results received: No. Last updated: 2026-06-09.

Condition(s): High grade brain tumors
Product: Tarlatamab, TEMOZOLOMIDE, Tarlatamab

Primary endpoint: Phase I: Dose limiting toxicities (DLT) defined as the following adverse event (AE) graded according to NCI CTCAE V5.0 or specific grading system for ICANS and CRS, assessed as related at least to tarlatamab, occurring during the first 2 cycles of treatment (i.e. DLT period is 8 weeks for DL1 or 12 weeks if DL-1 is investigated), Phase II: Objective response rate at 12 weeks (ORR-12W) according to immunotherapy Response Assessment for Neuro-Oncology (iRANO) criteria.
Endpoint(s): • Duration of response (DOR) • Disease Control Rate (DCR) • Time to Objective Response (ToR) • Progression Free Survival (PFS) • Overall Survival (OS), Nature, incidence and severity of AEs graded using CTCAE V5.0 or specific grading system for ICANS and CRS, Exploratory endpoint: Gene expression including DLL3 by RNASeq, , ctDNA dosing and sequencing, immunomonitoring on PBMC

Source: https://euclinicaltrials.eu/ctis-public/view/2023-510568-11-00